EU clinical trial 2024-517004-11-00: CPAAARI-Therapeutic efficacy comparison of a six-month treatment by itraconazole and nebulised Ambisome® versus treatment by itraconazole alone in non- or mildly- immunocompromised patients with Chronic Pulmonary Aspergillosis: a prospective, randomized, single blind study, (single aspergilloma excluded).
Protocol code: CPAAARI
Sponsor: Centre Hospitalier Universitaire De Poitiers (Hospital/Clinic/Other health care facility). Phase: Therapeutic confirmatory (Phase III). Countries: France (authorised, recruiting).
Therapeutic area(s): Phenomena and Processes [G] - Circulatory and Respiratory Physiological Phenomena [G09]
Gender: Female, Male. Age: 18-64 years, 65+ years. Enrolment: 224.
Status: Authorised, recruiting. Start date (EU): 2024-10-22. Decision date: 2024-10-22. Results received: No. Last updated: 2026-02-06.

Condition(s): Chronic pulmonary aspergillosis
Product: SALBUTAMOL, VFEND 200 mg film-coated tablets, AmBisome liposomal 50 mg Pulver zur Herstellung einer Infusionsdispersion, CHLORURE DE SODIUM PROAMP 0,9 %, solution injectable, SPORANOX 100 mg capsule rigide, Noxafil 100 mg gastro-resistant tablets

Primary endpoint: Therapeutic efficacy at 6 months is a composite criterion defined by the association of clinical improvement/stability and radiological improvement.
Endpoint(s): -Clinical evolution after 3 or 6 months: patient will be classified in one of 3 classes: improvement or stability or clinical deterioration./-Radiological evolution after 3 or 6 months: patient will be classified in one of 3 classes: improvement or stability or deterioration, -Major events during the 24-months follow-up period after stopping study treatment (i.e.; between visit M6 (at 6 months) and visit M30 (at 30 months)., Relapse during the 24-months follow-up period after stopping study treatment (between visits M6 and M30)., Mycological response after 3 and 6 months of study treatment., Number of medical consultations or hospitalizations for respiratory symptoms during the 6-month study treatment and the 24-month follow-up period, Clinical and biological tolerance, Improvement in quality of life evaluated by the VQ-11 Questionnaire, Concordance evaluation assessment between parameters for CPA diagnosis and evolution (see ancillary project annex 3 of this protocol)

Source: https://euclinicaltrials.eu/ctis-public/view/2024-517004-11-00